EU clinical trial 2024-515340-23-00: LEAn Body Mass Normalization of OXaliplatin Based Chemotherapy
Protocol code: ICM-URC2016/27
Sponsor: Institut Regional Du Cancer De Montpellier (Hospital/Clinic/Other health care facility). Phase: Therapeutic exploratory (Phase II). Countries: France (authorised, recruitment pending).
Therapeutic area(s): Diseases [C] - Neoplasms [C04]
Gender: Female, Male. Age: 18-64 years, 65+ years. Enrolment: 160.
Status: Authorised, recruitment pending. Decision date: 2024-08-22. Results received: No. Last updated: 2024-08-22.

Condition(s): Colon cancer

Source: https://euclinicaltrials.eu/ctis-public/view/2024-515340-23-00